EU clinical trial 2024-518494-34-00: A prospective, multicenter, phase II trial to assess the efficacy and safety of MRD-driven treatment with VEnetoclax and RItuximab combination in previously unTreated pAtients with chronic lymphocytic leukemia (VERITA PALG-CLL5 study)
Protocol code: VERITA PALG-CLL5
Sponsor: Polish Adult Leukemia Group (Patient organisation/association). Phase: Therapeutic exploratory (Phase II). Countries: Poland (ongoing, recruitment ended).
Therapeutic area(s): Diseases [C] - Neoplasms [C04]
Gender: Female, Male. Age: 18-64 years, 65+ years. Enrolment: 103.
Status: Ongoing, recruitment ended. Start date (EU): 2022-02-24. Decision date: 2024-12-02. Results received: No. Last updated: 2024-12-02.

Condition(s): Chronic lymphocytic leukemia
Product: MabThera 500 mg concentrate for solution for infusion, Venclyxto 100 mg film-coated tablets, Venclyxto 50 mg film-coated tablets, MabThera 100 mg concentrate for solution for infusion, Venclyxto 50 mg film-coated tablets, Venclyxto 10 mg film-coated tablets, Venclyxto 10 mg film-coated tablets

Primary endpoint: The proportion of patients who will achieve a CR or CRi with bone marrow MRD assessed by flow cytometry less than 10-4 at the end of treatment.
Endpoint(s): Overall Response Rate (ORR) Percentage of Participants with Best Overall Response (ORR)(defined as complete response [CR], CR [CRi], nodular partial response [nPR], PR) as assessed by investigator determined using iwCLL guidelines, Percentage of participants with MRD less than 10-4 in peripheral blood at 12 months following end of treatment, Duration of Responses (DOR) [time frame: response up to disease progression or death, whichever occurs first (up to approximately 5 years)]., Progression-Free Survival (PFS) [ time frame: baseline up to disease progression or death, whichever occurs first (up to approximately 5 years)] Investigator-Assessed Progression-Free Survival (PFS) determined using standard International Workshop on Chronic Lymphocytic Leukemia (iwCLL) guidelines, Overall Survival (OS) [time Frame: Baseline up to death (up to approximately 5 years)], Time to Next Anti-CLL Treatment (TTNT) [time frame: baseline up to next treatment or death from any cause, whichever occurs first (up to approximately 5 years)], Quality of life (QOL) of subjects during therapy. Changes from baseline in QOL measures assessed using the European Organization for Research and Treatment of Cancer Quality of Life Questionnaire Core 30 (EORTC QLQ-C30)., Evaluation of safety of VR treatment comprising all grades adverse events according to National Cancer Institute Common Terminology Criteria for Adverse Events, version 5.0 (NCI CTCAE, v.5.0)., To develop innovative, machine-learning-based algorithms to assess the prediction of response to VR treatment in CLL (as a probability of selected categories of response supported by rationale) based on patients’ electronic health records., To identify gut microbiota associated biomarkers that predict risk of development treatment-related toxicities (mainly infections) and kinetics and depth of response including undetectable MRD.

Source: https://euclinicaltrials.eu/ctis-public/view/2024-518494-34-00